EU clinical trial 2024-519626-21-00: IMMUNOPEC: Combination of neo-adjuvant Checkpoint Inhibition and Dendritic Cell Therapy (MesoPher) with Cytoreductive Surgery and Hyperthermic Intraperitoneal Chemotherapy in patients with Peritoneal Mesothelioma
Sponsor: Erasmus Universitair Medisch Centrum Rotterdam (Erasmus MC) (Hospital/Clinic/Other health care facility). Phase: Therapeutic exploratory (Phase II). Countries: Netherlands (authorised, recruitment pending).
Therapeutic area(s): Diseases [C] - Digestive System Diseases [C06]
Gender: Female, Male. Age: 18-64 years, 65+ years. Enrolment: 18.
Status: Authorised, recruitment pending. Decision date: 2025-04-09. Results received: No. Last updated: 2026-04-16.

Condition(s): Peritoneal Mesothelioma
Product: NIVOLUMAB

Primary endpoint: The progression free survival in patients that have received neo-adjuvant and adjuvant treatment with anti-PD-1 and vaccinations of DCT (5 administrations in total or less in case of production shortage) and cytoreduction.
Endpoint(s): Lymphocyte infiltration and activity will be measured by TCR repetoire analysis and immune phenotyping. Lymphocyte activity will be measured by apoptosis and proliferation markers using flow cytometry., Safety will be measured in AE’s and SAE’s, Radiological response will be measured using CT scans following RECIST 1.1 criteria, resulting in: progressive or stable disease and partial or complete response., PCI will be evaluated during DLS and can be compared to the PCI seen at CRS-HIPEC, Overall survival will be a secondary objective to evaluate.

Source: https://euclinicaltrials.eu/ctis-public/view/2024-519626-21-00